EU clinical trial 2024-513017-12-00: Optimizing treatment for children and adolescents with Juvenile Idiopathic Arthritis in sustained remission: a comparison of three treatment strategies. An open randomized multicenter trial assessing two different treatment withdrawal strategies compared to continued stable treatment with methotrexate and tumor necrosis factor inhibitor in children and adolescents with juvenile idiopathic arthritis in stable remission. The MOVE-JIA trial
Sponsor: Oslo University Hospital HF (Hospital/Clinic/Other health care facility). Phase: Therapeutic use (Phase IV). Countries: Norway (ongoing, recruiting).
Therapeutic area(s): Diseases [C] - Musculoskeletal Diseases [C05]; Diseases [C] - Immune System Diseases [C20]
Gender: Female, Male. Age: 0-17 years. Enrolment: 150.
Status: Ongoing, recruiting. Start date (EU): 2024-10-24. Decision date: 2024-08-28. Results received: No. Last updated: 2025-06-26.

Condition(s): Juvenile Idiopathic Arthritis
Product: GOLIMUMAB, ETANERCEPT, ADALIMUMAB, METHOTREXATE, METHOTREXATE, METHOTREXATE

Primary endpoint: The primary outcomes of this study are the proportion of study participants with a disease flare* during the first 12 months follow-up compared between each of the two drug withdrawal arms and the stable treatment arm., *Disease flare is defined as a combination of: A clinical significant increase in Juvenile Arthritis Disease Activity Score 27 (JADAS-27) ≥1.7 from baseline AND active joints ≥1 (swollen, or tender + limited range of motion) OR consensus between treating physician and participant/parents that a clinically significant flare has occurred with need of intensification of antirheumatic (DMARD) treatment.
Endpoint(s): The proportion of study participants with a disease flare* during the first 12 months follow-up compared between the two drug withdrawal arms., Time to flare and time to regain inactive disease after flare, Changes in validated measures of disease activity, Reports of adverse events, serious adverse events and suspected unexpected adverse reactions

Source: https://euclinicaltrials.eu/ctis-public/view/2024-513017-12-00